EU clinical trial 2023-505210-18-00: A Phase 3 Open-label Trial of Neoadjuvant Trastuzumab Deruxtecan (TDXd) Monotherapy or T-DXd followed by THP Compared to ddAC-THP in Participants with High-risk HER2-positive Early-stage Breast Cancer (DESTINY-Breast11)
Protocol code: D967RC00001
Sponsor: AstraZeneca AB (Pharmaceutical company). Phase: Therapeutic confirmatory (Phase III). Countries: Spain (ongoing, recruitment ended), Germany (ongoing, recruitment ended), Poland (ongoing, recruitment ended), Italy (ongoing, recruitment ended).
Therapeutic area(s): Diseases [C] - Neoplasms [C04]
Gender: Female, Male. Age: 18-64 years, 65+ years. Enrolment: 280.
Status: Ongoing, recruitment ended. Start date (EU): 2021-12-17. Decision date: 2024-10-01. Results received: No. Last updated: 2026-06-03.
Decision dates by country: IT: 2024-10-14, DE: 2024-10-02, PL: 2024-10-07, ES: 2024-10-01

Condition(s): Early stage HER2-positive breast cancer (T stage >= T3, lymph node positive, or inflammatory)
Product: CYCLOPHOSPHAMIDE, DOXORUBICIN, Herzuma 150 mg powder for concentrate for solution for infusion, Herzuma 420 mg powder for concentrate for solution for infusion, PACLITAXEL, CYCLOPHOSPHAMIDE, CYCLOPHOSPHAMIDE, Perjeta 420 mg concentrate for solution for infusion, DS-8201a, CYCLOPHOSPHAMIDE

Primary endpoint: pCR (ypT0/Tis ypN0): Rate of pCR is defined as the proportion of participants who have no evidence by H&E staining of residual invasive disease in the complete resected breast specimen and all sampled regional lymph nodes (ypT0/Tis ypN0) by central evaluation following completion of neoadjuvant therapy.
Endpoint(s): pCR (ypT0 ypN0): Rate of pCR is defined as the proportion of participants who have no evidence by H&E staining of residual invasive disease and in situ cancer in the complete resected breast specimen and all sampled regional lymph nodes (ypT0 ypN0) following completion of neoadjuvant therapy., EFS, IDFS, OS, HRQoL: Symptomatic AEs assessed by the PRO-CTCAE and items from the EORTC Item Library. Overall side-effect bother measured by PGI-TT at each time point in each treatment arm. Physical function assessed by the EORTC QLQ-C30 Physical Function Scale., Safety and Tolerability: Occurrence of AEs, SAEs and changes from baseline in vital signs, clinical laboratory results, ECGs, and ECHO/MUGA. Heart failure evaluated by the percentage of participants with NYHA Class III and IV heart failure. Decreases in LVEF (requires at least 2 consecutive readings of decline) by percentage of participants with decreases in LVEF of at least 10 points from baseline and to below 50%., PK of T-DXd: Serum concentration of T-DXd, anti-HER2 antibody, and DXd., Immunogenicity for T-DXd: Number and percentage of participants who develop ADAs for T-DXd.

Source: https://euclinicaltrials.eu/ctis-public/view/2023-505210-18-00